EU clinical trial 2022-502049-91-00: A RANDOMIZED, DOUBLE-BLIND, PLACEBO-CONTROLLED MULTICENTER STUDY TO EVALUATE THE EFFICACY AND SAFETY OF CAL02 ADMINISTERED INTRAVENOUSLY IN ADDITION TO STANDARD OF CARE IN SUBJECTS WITH SEVERE COMMUNITY-ACQUIRED BACTERIAL PNEUMONIA (SCABP)
Protocol code: EGL-6535-C-2202
Sponsor: Eagle Pharmaceuticals Inc. (Pharmaceutical company). Phase: Therapeutic exploratory (Phase II). Countries: Greece (temporarily halted), Latvia (temporarily halted), Hungary (temporarily halted), Slovakia (temporarily halted), Romania (temporarily halted), Czechia (temporarily halted), Belgium (temporarily halted), Spain (temporarily halted), France (temporarily halted).
Therapeutic area(s): Diseases [C] - Bacterial Infections and Mycoses [C01]
Gender: Female, Male. Age: 18-64 years, 65+ years. Enrolment: 81.
Status: Temporarily halted. Start date (EU): 2023-09-26. Decision date: 2023-06-14. Results received: No. Last updated: 2025-09-24.
Decision dates by country: HU: 2023-07-21, GR: 2023-07-25, RO: 2023-06-14, SK: 2023-07-17, CZ: 2023-06-28, LV: 2023-07-21, FR: 2023-08-04, BE: 2023-10-19, ES: 2023-06-30

Condition(s): SEVERE COMMUNITY-ACQUIRED BACTERIAL PNEUMONIA (SCABP)
Product: Natriumchloride 0,9%, oplossing voor infusie, CAL02

Primary endpoint: Time (days) to clinical recovery, the day all severity criteria which met the SCABP definition per protocol at randomization, and any new severity criteria which occurred after randomization, are resolved, and no repeat or additional severity criteria are met within 24 hours after recovery, Incidence and severity of TEAEs including infusion-related reactions, Incidence of IMP IV infusion interruptions and discontinuations
Endpoint(s): Time to critical care management discharge (days), Time to hospital discharge (days), Proportion of subjects who achieve clinical recovery by Day 5, Relative change from baseline in whole SOFA score at Day 7

Source: https://euclinicaltrials.eu/ctis-public/view/2022-502049-91-00